EU clinical trial 2023-508184-74-00: A trial to determine how nanatinostat is absorbed, modified, and removed from the body and the amount of nanatinostat that becomes available to the body in patients with cancers that is very large or has spread to other parts of the body
Protocol code: VT3996-102
Sponsor: Viracta Therapeutics Inc. (Pharmaceutical company). Phase: Human Pharmacology (Phase I)- Other. Countries: Spain (ended).
Therapeutic area(s): Diseases [C] - Neoplasms [C04]
Gender: Female, Male. Age: 18-64 years. Enrolment: 20.
Status: Ended. Start date (EU): 2024-02-28. End date (EU): 2025-01-15. End date: 2025-01-16. Decision date: 2024-02-12. Results received: No. Last updated: 2024-08-30.
Decision dates by country: ES: 2024-05-07

Condition(s): Advanced cancer

Source: https://euclinicaltrials.eu/ctis-public/view/2023-508184-74-00